EU clinical trial 2024-517636-22-00: Synaptic density and tau pathology in Alzheimer’s disease (SYNAPSE)
Sponsor: Amsterdam UMC Stichting (Patient organisation/association). Phase: Therapeutic exploratory (Phase II). Countries: Netherlands (ended).
Therapeutic area(s): Diseases [C] - Nervous System Diseases [C10]
Gender: Female, Male. Age: 18-64 years, 65+ years. Enrolment: 30.
Status: Ended. Start date (EU): 2024-12-10. End date (EU): 2026-01-21. Decision date: 2024-12-10. Results received: No. Last updated: 2024-12-10.

Condition(s): Alzheimer's disease
Product: 18F-Synvest-1, Flortaucipir

Primary endpoint: Quantification of brain regional [18F]SynVesT-1 uptake (synaptic density) and regional [ 18F]flortaucipir uptake (tau)
Endpoint(s): association between [18F]Flortaucipir (tau) binding and [18F]SynVesT-1 (synaptic density) binding

Source: https://euclinicaltrials.eu/ctis-public/view/2024-517636-22-00